EU clinical trial 2024-511127-33-00: Statins to Prevent Immune checkpoint inhibitor-induced pRogression of AtheroscLerosis
Sponsor: Erasmus Universitair Medisch Centrum Rotterdam (Erasmus MC) (Hospital/Clinic/Other health care facility). Phase: Therapeutic use (Phase IV). Countries: Netherlands (ongoing, recruiting).
Therapeutic area(s): Diseases [C] - Neoplasms [C04]; Diseases [C] - Cardiovascular Diseases [C14]
Gender: Female, Male. Age: 18-64 years, 65+ years. Enrolment: 172.
Status: Ongoing, recruiting. Start date (EU): 2026-01-19. Decision date: 2025-05-12. Results received: No. Last updated: 2026-07-07.

Condition(s): Atherosclerosis
Product: PLACEBO, ATORVASTATIN

Primary endpoint: Annualized percentage change in non-calcified atherosclerotic plaque volume in the thoracic aorta in the intervention versus the control group.
Endpoint(s): Annualized percentage change in total and calcified atherosclerotic plaque volume in the thoracic aorta in the intervention versus the control group, Annualized percentage change in total, non-calcified and calcified coronary artery atherosclerotic plaque volume in the intervention versus the control group., Annualized change in coronary calcification score (Agatston score) and MESA score in the intervention versus the control group., Annualized change in epicardial fat volume in the intervention versus the control group p, Difference in reactive hyperaemia index as a marker of endothelial dysfunction using peripheral arterial tonometry (EndoPAT) between intervention and control group., Difference in quality of life between intervention and control group at baseline, 3 months, 6 months and 1 year after the start of ICI therapy, Differences in the number of adverse events between intervention and control group during the first year after start of ICI therapy, graded according to CTCAE criteria, version 5.0.

Source: https://euclinicaltrials.eu/ctis-public/view/2024-511127-33-00